EU clinical trial 2026-526224-48-02: Bioequivalence study of Vitamin D3 Pharma Patent 20,000 IU and the Vigantol 20,000 IU oral drops solutions and assessment of bioavailability in healthy volunteers
Protocol code: PAT24-BES
Sponsor: Pharma Patent Kft. (Pharmaceutical company). Phase: Human Pharmacology (Phase I)- Bioequivalence Study. Countries: Hungary (authorised, recruitment pending).
Therapeutic area(s): Not possible to specify
Gender: Female, Male. Age: 18-64 years. Enrolment: 36.
Status: Authorised, recruitment pending. Decision date: 2026-07-17. Results received: No. Last updated: 2026-07-17.

Condition(s): Healthy volunteers

Source: https://euclinicaltrials.eu/ctis-public/view/2026-526224-48-02